EU clinical trial 2025-522347-18-00: A 6-Week, Multicenter, Open-Label, Monotherapy, Extension Study of SPT-300 in Adults with Major Depressive Disorder, With or Without Anxious Distress
Protocol code: SPT-300-2024-204
Sponsor: Seaport Therapeutics Inc. (Pharmaceutical company). Phase: Therapeutic exploratory (Phase II). Countries: Bulgaria (ongoing, recruiting), Czechia (ongoing, recruiting), Germany (ongoing, recruiting), Poland (ongoing, recruiting), Hungary (authorised, recruiting), Slovakia (ongoing, recruiting), Romania (ended).
Therapeutic area(s): Psychiatry and Psychology [F] - Mental Disorders [F03]
Gender: Female, Male. Age: 18-64 years, 65+ years. Enrolment: 250.
Start date (EU): 2025-11-26. Decision date: 2025-11-06. Results received: No. Last updated: 2026-07-27.
Decision dates by country: PL: 2025-11-13, HU: 2025-11-10, RO: 2025-11-11, SK: 2025-11-06, DE: 2025-11-07, BG: 2025-11-11, CZ: 2025-11-07

Condition(s): Major Depressive Disorder (MDD), with or without Anxious Distress

Primary endpoint: Incidence, severity, and duration of treatment-emergent adverse events, serious adverse events, and incidence of clinically significant vital signs, electrocardiograms, safety laboratory, and physical examination findings, Suicidal ideation and behavior using the Columbia Suicide Severity Rating Scale
Endpoint(s): Change from Baseline to Visit 6 (Study Day 42) in the following: • HAM-D-17 total score • CGI-S • Hamilton Anxiety Rating Scale • PGI-S • Sheehan Disability Scale • The Quality of Life, Enjoyment, and Satisfaction Questionnaire-Short Form

Source: https://euclinicaltrials.eu/ctis-public/view/2025-522347-18-00